EU clinical trial 2022-501621-20-00: INCB 18424-319: A phase 3, double-blind, randomised, vehicle-controlled, efficacy and safety study of ruxolitinib cream in participants with Purigo Nodularis. Topical ruxolitinib evaluation in Prurigo Nodularis (TRuE-PN1)
Protocol code: INCB18424-319
Sponsor: Incyte Corp. (Pharmaceutical company). Phase: Therapeutic confirmatory (Phase III). Countries: Spain (ended), Italy (ended), Belgium (ended), France (ended), Germany (ended), Netherlands (ended), Poland (ended).
Therapeutic area(s): Diseases [C] - Skin and Connective Tissue Diseases [C17]; Diseases [C] - Immune System Diseases [C20]
Gender: Female, Male. Age: 18-64 years, 65+ years. Enrolment: 68.
Status: Ended. Start date (EU): 2023-10-02. End date (EU): 2025-04-23. End date: 2025-08-13. Decision date: 2023-08-18. Results received: Yes. Last updated: 2025-04-28.
Decision dates by country: NL: 2023-08-18, PL: 2023-08-28, IT: 2023-08-22, ES: 2023-08-22, DE: 2023-08-23, FR: 2023-08-21, BE: 2023-08-18

Condition(s): Prurigo Nodularis
Product: Vehicle cream (same formulation of cream as the test product but without active substance), Ruxolitinib cream

Primary endpoint: WI-NRS4 response at Week 12, defined as achieving a ≥ 4-point improvement (reduction) in WI-NRS score from baseline.
Endpoint(s): WI-NRS4 response at Week 4., Overall-TS at Week 12, defined as achieving both a WI-NRS4 response and an IGA CPG S TS. (IGA-CPG-S-TS is defined as an IGA-CPG-S score of 0 or 1 with a ≥ 2 grade improvement from baseline.), IGA-CPG-S-TS at Week 12., WI-NRS4 response on Day 7.

Source: https://euclinicaltrials.eu/ctis-public/view/2022-501621-20-00